EU clinical trial 2025-523403-29-00: A Randomized, Double-blinded, Placebo-controlled, Parallel Group, Phase 2a Study to Assess the Activity, Safety, and Tolerability of SAR445399 in Adult Participants with Non-Cystic Fibrosis Bronchiectasis (NCFB).
Protocol code: PDY19372
Sponsor: Sanofi-Aventis Recherche & Developpement (Pharmaceutical company). Phase: Therapeutic exploratory (Phase II). Countries: Poland (authorised, recruitment pending), Spain (authorised, recruitment pending), France (authorised, recruitment pending), Netherlands (authorised, recruitment pending), Germany (authorised, recruitment pending).
Therapeutic area(s): Diseases [C] - Respiratory Tract Diseases [C08]
Gender: Female, Male. Age: 18-64 years, 65+ years. Enrolment: 41.
Status: Authorised, recruitment pending. Decision date: 2026-06-23. Results received: No. Last updated: 2026-06-30.
Decision dates by country: DE: 2026-06-23, ES: 2026-06-24, NL: 2026-06-25, PL: 2026-06-26, FR: 2026-06-24

Condition(s): Non-cystic fibrosis bronchiectasis
Product: SAR445399, Matched placebo for test product

Primary endpoint: Change from baseline to Week 24 in mucus plug score (MPS) derived from chest high-resolution computerized tomography (HRCT)
Endpoint(s): Change from baseline to Week 24 in post-bronchodilator forced expiratory volume in 1 second (FEV1), Change from baseline to Week 52 in post-bronchodilator forced expiratory volume in 1 second (FEV1), Change from baseline to Week 24 in pre-bronchodilator forced expiratory volume in 1 second (FEV1), Change from baseline to Week 52 in pre-bronchodilator forced expiratory volume in 1 second (FEV1), Annualized rate of pulmonary exacerbation (PEx) from baseline up to Week 24, Annualized rate of pulmonary exacerbation (PEx) from baseline up to Week 52, Responder status for being exacerbation-free over the 24-week study period, Responder status for being exacerbation-free over the 52-week study period, Annualized rate of severe pulmonary exacerbation (PEx) from baseline up to Week 24, Annualized rate of severe pulmonary exacerbation (PEx) from baseline up to Week 52, Responder status for being severe exacerbation-free over the 24-week study period, Responder status for being severe exacerbation-free over the 52-week study period, Incidence of treatment-emergent adverse events (TEAEs), adverse event of special interests (AESIs), serious adverse events (SAEs), adverse events (AEs) leading to permanent study treatment discontinuation throughout the study, Incidence of potentially clinically significant abnormalities in laboratory tests, vital signs, and 12-lead electrocardiograms (ECGs) throughout the study, Plasma concentration of SAR445399 at prespecified timepoints throughout the study, Incidence of anti-drug antibodies (ADAs) against SAR445399 throughout the study

Source: https://euclinicaltrials.eu/ctis-public/view/2025-523403-29-00